EU clinical trial 2025-522119-41-00: Effect of Empagliflozin in patients with eGFR between 10 and 20 ml/min/1.73m2 - EMPA [10-20]
Sponsor: Centre Hospitalier Universitaire De Nice (Hospital/Clinic/Other health care facility). Phase: Therapeutic confirmatory (Phase III). Countries: France (authorised, recruitment pending).
Therapeutic area(s): Analytical, Diagnostic and Therapeutic Techniques and Equipment [E] - Therapeutics [E02]
Gender: Female, Male. Age: 18-64 years, 65+ years. Enrolment: 34.
Status: Authorised, recruitment pending. Decision date: 2026-03-05. Results received: No. Last updated: 2026-03-05.

Condition(s): Patients with renal impairment and type 2 diabetes.
Product: Jardiance 10 mg film-coated tablets, Placebo is identical in composition to empagliflozin but does not contain the iSGLT2 active substance.

Primary endpoint: 1/ Changes in mean UACR on spot morning urine samples between 2 days running at baseline and 2 days running at the end of each 6-week treatment period (empagliflozin 10 mg/d and matching placebo). 2/ Changes in mean UPCR on spot morning urine samples between 2 days running at baseline and 2 days running at the end of each 6-week treatment period (empagliflozin 10 mg/d and matching placebo).
Endpoint(s): 1/Changes in body weight between baseline and at the end of each 6-week treatment period (empagliflozin 10 mg/d and matching placebo)., 2/a) Changes in mean 24-hour urinary sodium excretion and urinary volume between 3 days running urinary collections at baseline and 3 days after starting each treatment period (empagliflozin 10 mg/d and matching placebo). The measures will be the mean of each 3 days period., 2/b) Changes in mean ambulatory systolic blood pressure between 3 days running baseline and 3 days running at the end of each 6-week treatment period (empagliflozin 10 mg/d and matching placebo),, 2/c) Changes in serum potassium levels between baseline and every week during each 6-week treatment period (empagliflozin 10 mg/d and matching placebo), changes in serum bicarbonate levels between baseline and every week during each 6-week treatment period (empagliflozin 10 mg/d and matching placebo)., 2/d) Description of treatment emergent adverse events (TEAEs) and serious adverse events (SAEs), (no acute kidney injury or hyperkalaemia > 5.5 mmol/L or acidosis (serum bicarbonate <23 mmol/L)), 3/ Changes in HbA1C between baseline and at the end of each 6-week treatment period (empagliflozin 10 mg/d and matching placebo)., 4/ To show that mean 24-hour albuminuria decreases in the empagliflozine group compare to placebo group in the 3 days following the beginning of the treatment compare to the 3 days before. The measures will be the mean of each 3 days period

Source: https://euclinicaltrials.eu/ctis-public/view/2025-522119-41-00